EU clinical trial 2023-508170-28-00: Effects of NNC0194-0499 alone and in combination with semaglutide, of semaglutide alone, and of cagrilintide alone and in combination with semaglutide on liver damage and alcohol use in people with alcohol-related liver disease
Protocol code: NN9500-7730
Sponsor: Novo Nordisk A/S (Pharmaceutical company). Phase: Therapeutic exploratory (Phase II). Countries: Germany (ended), Greece (ended), Bulgaria (ended), France (ended), Denmark (ended), Czechia (ended), Italy (ended), Poland (ended), Netherlands (ended), Spain (ended).
Therapeutic area(s): Diseases [C] - Nutritional and Metabolic Diseases [C18]
Gender: Female, Male. Age: 18-64 years, 65+ years. Enrolment: 140.
Status: Ended. Start date (EU): 2024-08-07. End date (EU): 2026-01-12. End date: 2026-01-13. Decision date: 2024-05-29. Results received: No. Last updated: 2025-12-18.
Decision dates by country: IT: 2024-05-29, ES: 2024-05-29, PL: 2024-06-03, NL: 2024-05-29, DE: 2024-05-29, FR: 2024-05-29, BG: 2024-06-03, DK: 2024-05-29, GR: 2024-06-03, CZ: 2024-05-29

Condition(s): alcohol-related liver disease
Product: cagrilintide semaglutide, cagrilintide, cagrilintide semaglutide, Placebo (zalfermin) + Placebo (semaglutide), semaglutide, Placebo (cagrilintide) + placebo (semaglutide), cagrilintide semaglutide, cagrilintide, cagrilintide semaglutide, cagrilintide, cagrilintide semaglutide, zalfermin, cagrilintide, cagrilintide

Primary endpoint: Change in Enhanced Liver Fibrosis (ELF)
Endpoint(s): Supportive secondary endpoints:, Change in Pro-peptide of Collagen 3 (Pro-C3), Change in liver stiffness assessed by Vibration Controlled Transient Elastography (VCTE), Change in liver steatosis assessed by Controlled Attenuated Parameter (CAP), Change in Alanine Aminotransferase (ALT), Change in Aspartate Aminotransferase (AST), Supportive secondary endpoints to secondary objectives:, Number of treatment-emergent adverse events, Change in Phosphatidylethanol (PEth), Change in alcohol amount measured by timeline follow-back (TLFB), Change in total cholesterol

Source: https://euclinicaltrials.eu/ctis-public/view/2023-508170-28-00